EU clinical trial 2024-518780-36-00: A Phase 1b open label pilot study of CLN-978 for the treatment of moderate to severe systemic lupus erythematosus (SLE)
Protocol code: CLN-978-SL-101
Sponsor: Cullinan Therapeutics Inc. (Pharmaceutical company). Phase: Human Pharmacology (Phase I)- Other. Countries: Bulgaria (ongoing, recruiting), Romania (ongoing, recruiting), France (authorised, recruiting), Germany (authorised, recruitment pending), Spain (authorised, recruitment pending), Poland (authorised, recruitment pending).
Therapeutic area(s): Diseases [C] - Musculoskeletal Diseases [C05]
Gender: Female, Male. Age: 18-64 years, 65+ years. Enrolment: 44.
Start date (EU): 2025-12-10. Decision date: 2025-11-25. Results received: No. Last updated: 2026-05-20.
Decision dates by country: BG: 2025-11-25, DE: 2026-04-08, ES: 2026-04-01, PL: 2026-04-29, FR: 2026-04-10, RO: 2026-03-16

Condition(s): Systemic Lupus Erythematosus

Source: https://euclinicaltrials.eu/ctis-public/view/2024-518780-36-00